EU clinical trial 2022-501883-17-00: (21196) A multicenter, prospective, open-label study to evaluate the pharmacokinetics and safety of gadoquatrane in pediatric participants (from birth to <18 years) undergoing contrast-enhanced magnetic resonance imaging (CE-MRI)
Protocol code: 21196
Sponsor: Bayer AG (Pharmaceutical company). Phase: Therapeutic confirmatory (Phase III). Countries: Poland (ended), Sweden (ended), Czechia (ended), Hungary (ended), Bulgaria (ended), Germany (ended), Italy (not authorised).
Therapeutic area(s): Analytical, Diagnostic and Therapeutic Techniques and Equipment [E] - Diagnosis [E01]
Gender: Female, Male. Age: 0-17 years. Enrolment: 74.
Status: Ended. Start date (EU): 2023-10-16. End date (EU): 2024-11-21. End date: 2024-11-22. Decision date: 2023-10-03. Results received: Yes. Last updated: 2024-09-25.
Decision dates by country: BG: 2023-10-04, HU: 2023-10-04, SE: 2023-10-03, PL: 2023-10-04, CZ: 2023-10-03, DE: 2023-10-05

Condition(s): Contrast enhancement in magnetic resonance imaging in children
Product: BAY 1747846

Primary endpoint: Area under the curve (AUC) of gadoquatrane after single administration, Plasma clearance normalized to body weight (CL/BW) of gadoquatrane after single administration, Apparent volume of distribution at steady state normalized to body weight (Vss/bw), Simulation of plasma concentration at 20 minutes post-injection (C20)
Endpoint(s): Number and intensity of treatment-emergent AEs (TEAEs), including number of SAEs, occurring within 24 (±4) hours post-injection or in the post-treatment period of 7 (±1) days after the day of study intervention

Source: https://euclinicaltrials.eu/ctis-public/view/2022-501883-17-00